EU clinical trial 2023-506787-13-00: Evaluation of the effects of oral nicotine substitutes (1.5mg lozenge) on the craving in moderate smokers placed in non-smoking situations. A randomized, double-blind, placebo-controlled parallel groups trial.
Protocol code: V00018PC303
Sponsor: Pierre Fabre Medicament (Pharmaceutical company). Phase: Therapeutic confirmatory (Phase III). Countries: Bulgaria (ended).
Therapeutic area(s): Not possible to specify
Gender: Female, Male. Age: 18-64 years, 65+ years. Enrolment: 180.
Status: Ended. Start date (EU): 2024-04-03. End date (EU): 2024-05-23. Decision date: 2024-02-07. Results received: Yes. Last updated: 2024-02-07.

Condition(s): Cessation of smoking
Product: NICOPASS 1,5 mg SANS SUCRE MENTHE FRAICHEUR, pastille édulcorée à l'aspartam et à l’acésulfame potassique, V0018 Placebo

Primary endpoint: Questionnaire of Smoking Urges (QSU)-brief Total score change from baseline at 30 minutes and any earlier times using.
Endpoint(s): QSU-brief Total score improvement from Baseline., QSU-brief Total score change from baseline at 45, 60 and 90 minutes., Area under curve of QSU-brief Total score improvement from baseline over 30 minutes., • VAS Global evaluation of the craving during the day. • Number of lozenges., Change from baseline Minnesota Nicotine Withdrawal Scale (MNWS) score at the end of Day 1., 5 points Lickert scale., Incidence, severity, causality and outcomes of treatment-emergent adverse events (TEAEs), treatment emergent serious adverse events (TESAEs). Clinically significant abnormalities in physical examinations and vitals signs measurements.

Source: https://euclinicaltrials.eu/ctis-public/view/2023-506787-13-00